EU clinical trial 2024-512029-10-00: A phase 3b, Randomized, Controlled Trial of Nadofaragene Firadenovec vs. Observation in Subjects with Intermediate Risk Non-Muscle Invasive Bladder Cancer (IR NMIBC)
Protocol code: 000423
Sponsor: Ferring Pharmaceuticals A/S (Pharmaceutical company). Phase: Therapeutic confirmatory (Phase III). Countries: France (ongoing, recruiting), Denmark (authorised, recruiting), Spain (ongoing, recruiting), Czechia (ongoing, recruiting), Italy (authorised, recruitment pending), Poland (ongoing, recruiting).
Therapeutic area(s): Diseases [C] - Female Urogenital Diseases and Pregnancy Complications [C13]; Diseases [C] - Male Urogenital Diseases [C12]
Gender: Female, Male. Age: 18-64 years, 65+ years. Enrolment: 296.
Start date (EU): 2025-12-05. Decision date: 2025-03-25. Results received: No. Last updated: 2026-07-06.
Decision dates by country: DK: 2025-03-25, CZ: 2026-03-09, FR: 2025-03-26, IT: 2026-03-09, ES: 2025-03-26, PL: 2026-03-13

Condition(s): Intermediate risk, non-muscle invasive bladder cancer
Product: ADSTILADRIN

Primary endpoint: The primary endpoint is recurrence-free survival (RFS), defined as the time from the date of randomization to first documented recurrence or progression (as defined in the below table), or death (due to any cause), whichever occurs first during the treatment period (24 months).

Source: https://euclinicaltrials.eu/ctis-public/view/2024-512029-10-00